EU clinical trial 2024-517031-51-00: A Phase I-IIa Trial on the Safety and Preliminary Effectiveness of Intramyocardial Injection of Cardiac Atrial Stem Cells for the Treatment of Advanced Ischemic Heart Failure in Subjects with Ischemic Left Ventricular Dysfunction and Chronic Myocardial Infarction.
Sponsor: CASC8 (SME). Phase: Phase I and Phase II (Integrated)- First administration to humans. Countries: Belgium (not authorised).
Therapeutic area(s): Diseases [C] - Cardiovascular Diseases [C14]
Gender: Female, Male. Age: 18-64 years, 65+ years. Enrolment: 20.
Status: Not authorised. Decision date: 2025-08-27. Results received: No. Last updated: 2025-08-27.

Condition(s): Heart Failure
Product: Cardiac atrial stem cells

Primary endpoint: MACE : • Death and cause of death, MACE : • Re-admissions and cause of re-admission, MACE : • Myocardial infarction, MACE : • Tumour formation
Endpoint(s): safety - non-MACE : • worsening of heart failure events defined as requiring unscheduled treatment for signs and symptoms of heart failure in an urgent outpatient setting or requiring hospital admission, safety - non - MACE: • aborted sudden death events, defined as resuscitated sudden death or appropriate Automatic Implantable Cardioverter Defibrillator (AICD) therapy for severe ventricular tachyarrhythmias, safety - non-MACE : • change in Six-Minute Walk Test from pre-procedure, safety - non-safety : • total days alive out of hospital, safety - non - MACE : • changes in NYHA class from pre-procedure and proportion of patients with improved NYHA classification, efficacy : • global and regional left ventricular function, efficacy : • ventricular dimensions, efficacy : • measurements of infarct size

Source: https://euclinicaltrials.eu/ctis-public/view/2024-517031-51-00